EU clinical trial 2024-510885-17-01: Defining the Glucagon Unit: Investigating the Impact on Energy Expenditure and Glucose Level Deviation in healthy volunteers
Protocol code: VPP-EM-2022/1-0001
Sponsor: Pauls Stradins Clinical University Hospital (Hospital/Clinic/Other health care facility). Phase: Human Pharmacology (Phase I)- Other. Countries: Latvia (ended).
Therapeutic area(s): Diseases [C] - Nutritional and Metabolic Diseases [C18]
Gender: Male. Age: 18-64 years. Enrolment: 10.
Status: Ended. Start date (EU): 2025-06-01. End date (EU): 2025-06-01. Decision date: 2024-06-28. Results received: Yes. Last updated: 2024-06-28.

Condition(s): Obesity
Product: SEMAGLUTIDE, GLUCAGON

Primary endpoint: Change from baseline in resting energy expenditure (EE) measured by indirect calorimetry after intervention with glucose, intravenous glucose, intravenous glucagon, semaglutide, saline, and additional glucagon infusion.
Endpoint(s): Change from baseline in respiratory quotient (RQ) measured by indirect calorimetry after intervention with glucose, intravenous glucose, intravenous glucagon, semaglutide, saline, and additional glucagon infusion., Change from baseline in carbohydrate oxidation rates measured by indirect calorimetry after intervention with glucose, intravenous glucose, intravenous glucagon, semaglutide, saline, and additional glucagon infusion., Change from baseline in fat oxidation rates measured by indirect calorimetry after intervention with glucose, intravenous glucose, intravenous glucagon, semaglutide, saline, and additional glucagon infusion., Changes in blood levels of insulin, glucose, GLP-1, and glucagon at predetermined intervals after intervention with glucose, intravenous glucose, intravenous glucagon, semaglutide, saline, and additional glucagon infusion., Side effects reported during the self-observation weeks after each intervention., Body weight changes throughout the study period, including before and after each intervention., Comparison of postprandial glucose excursion between different interventions, measured by continuous glucose monitoring (CGM)., Assessment of changes in urinary nitrogen excretion as a measure of protein metabolism in response to interventions.

Source: https://euclinicaltrials.eu/ctis-public/view/2024-510885-17-01